EU clinical trial 2025-522635-34-00: A Study to Evaluate the Effect of TRIV-509 on Skin Barrier Function in Patients with Atopic Dermatitis.
Protocol code: 509-102/ CHDR2443
Sponsor: Triveni Bio Inc. (Pharmaceutical company). Phase: Human Pharmacology (Phase I)- Other. Countries: Netherlands (ended).
Therapeutic area(s): Diseases [C] - Skin and Connective Tissue Diseases [C17]
Gender: Female, Male. Age: 18-64 years, 65+ years. Enrolment: 48.
Status: Ended. Start date (EU): 2025-10-09. End date (EU): 2026-07-27. Decision date: 2025-10-07. Results received: No. Last updated: 2026-01-21.

Condition(s): Atopic Dermatitis

Source: https://euclinicaltrials.eu/ctis-public/view/2025-522635-34-00